EU clinical trial 2024-516625-31-00: Subcutaneous Trastuzumab Deruxtecan Phase 1 Trial.
Protocol code: DS8201-801
Sponsor: Daiichi Sankyo Inc. (Pharmaceutical company). Phase: Human Pharmacology (Phase I)- Other. Countries: Spain (ongoing, recruiting), France (ongoing, recruiting).
Therapeutic area(s): Diseases [C] - Neoplasms [C04]
Gender: Female, Male. Age: 18-64 years, 65+ years. Enrolment: 25.
Status: Ongoing, recruiting. Start date (EU): 2025-11-25. Decision date: 2025-10-30. Results received: No. Last updated: 2026-04-22.
Decision dates by country: ES: 2025-11-03, FR: 2025-10-30

Condition(s): Advanced Solid Tumor

Source: https://euclinicaltrials.eu/ctis-public/view/2024-516625-31-00